EU clinical trial 2025-522409-39-00: Immune Cell Therapy for People with Early, Active Multiple Sclerosis
Protocol code: STop MS
Sponsor: Medizinische Hochschule Hannover (Educational Institution). Phase: Human Pharmacology (Phase I)- Other. Countries: Germany (authorised, recruitment pending).
Therapeutic area(s): Diseases [C] - Nervous System Diseases [C10]
Gender: Female, Male. Age: 18-64 years, 65+ years. Enrolment: 10.
Status: Authorised, recruitment pending. Decision date: 2026-07-24. Results received: No. Last updated: 2026-07-24.

Condition(s): Newly diagnosed highly-active Multiple Sclerosis

Source: https://euclinicaltrials.eu/ctis-public/view/2025-522409-39-00